EU clinical trial 2024-512937-34-00: RANDOMIZED, DOUBLE BLIND, PLACEBO CONTROLLED, TWO-ARMS, MULTICENTER, POST AUTHORIZATION EFFICACY AND SAFETY STUDY (PAES) TO CONFIRM AND COLLECT MORE CLINICAL DATA OF BUCCALIN® TABLETS IN THE PROPHYLAXIS OF RECURRENT LOWER RESPIRATORY TRACT INFECTIONS (RLRTIs).
Protocol code: BUC-01-23
Sponsor: Laboratorio Farmaceutico S.I.T. - Specialita' Igienico Terapeutiche S.r.l. (Pharmaceutical company). Phase: Therapeutic use (Phase IV). Countries: Italy (ongoing, recruiting).
Therapeutic area(s): Diseases [C] - Respiratory Tract Diseases [C08]
Gender: Female, Male. Age: 18-64 years, 65+ years. Enrolment: 216.
Status: Ongoing, recruiting. Start date (EU): 2025-08-06. Decision date: 2024-10-17. Results received: No. Last updated: 2025-08-06.

Condition(s): RECURRENT LOWER RESPIRATORY TRACT INFECTIONS (RLRTIS).
Product: Placebo (Seven gastro-resistant tablets containing only excipients): Lactose, microcrystalline cellulose, colloidal anhydrous silica, magnesium stearate, eudragit L 100-55, sodium hydroxide, talc, triethyl citrate, titanium dioxide, iron oxide red, iron oxide yellow, iron oxide black, opaglos., Buccalin Adulti compresse gastroresistenti

Primary endpoint: Reduction in the number of infection episodes in the treatment period (12 months) in the Buccalin® group versus the Placebo group.
Endpoint(s): Reduction in the number of infection episodes during 3, 6 and 9 months of treatment will be assessed., Mean duration in days per RLRTI during the Treatment period and during the Follow up period will be assessed., Number of antibiotic treatments for a respiratory event during the Treatment period and during the Follow-up period will be assessed., Number of sick days for patients or caregiver during the Treatment period and during the Follow-up period will be assessed., During the treatment period the patients were asked to fill in a Visual Analogue Scale (VAS) ranging from 0 (the worse) to 10 (the best situation)., Quantitative and Qualitative Evaluation of Safety in terms of adverse events reported.

Source: https://euclinicaltrials.eu/ctis-public/view/2024-512937-34-00